EU clinical trial 2023-509296-16-00: A randomized, subject and investigator blinded, placebo controlled and multi-center platform study, to assess efficacy and safety of different investigational drugs in patients with moderate to severe hidradenitis suppurativa
Protocol code: CCFZ533H12201BC
Sponsor: Novartis Pharma AG (Pharmaceutical company). Phase: Therapeutic exploratory (Phase II). Countries: Hungary (ended), Austria (ended), Germany (ended), France (ended), Spain (ended), Belgium (ended).
Therapeutic area(s): Diseases [C] - Skin and Connective Tissue Diseases [C17]
Gender: Female, Male. Age: 18-64 years, 65+ years. Enrolment: 245.
Status: Ended. Start date (EU): 2019-06-17. End date (EU): 2025-10-21. Decision date: 2024-05-10. Results received: No. Last updated: 2025-03-31.
Decision dates by country: FR: 2024-05-15, AT: 2024-05-12, HU: 2024-05-10, DE: 2024-05-14, ES: 2024-05-10, BE: 2024-06-10

Condition(s): Moderate to severe hidradenitis suppurativa
Product: VAY736, Placebo Solution for injection or infusion 0 mg/1 mL

Primary endpoint: Proportion of patients achieving clinical response evaluated by the simplified Hidradenitis Suppurativa Clinical Response (HiSCR) after 16 weeks of treatment
Endpoint(s): Number and severity of adverse events, Physical examination, vital signs, safety laboratory measurements, ECGs

Source: https://euclinicaltrials.eu/ctis-public/view/2023-509296-16-00